EU clinical trial 2025-521154-42-00: Phase 2a, Multicenter, Randomized, Double-blind, Placebo-controlled Study to Assess the Safety of Anumigilimab (CSL324) in Adults with Sickle Cell Disease
Protocol code: CSL324_2002
Sponsor: CSL Behring LLC (Pharmaceutical company). Phase: Therapeutic exploratory (Phase II). Countries: Belgium (authorised, recruiting), Netherlands (authorised, recruiting), France (authorised, recruiting), Italy (authorised, recruiting).
Therapeutic area(s): Diseases [C] - Hemic and Lymphatic Diseases [C15]
Gender: Female, Male. Age: 18-64 years, 65+ years. Enrolment: 12.
Status: Authorised, recruiting. Start date (EU): 2026-05-28. Decision date: 2026-04-28. Results received: No. Last updated: 2026-07-28.
Decision dates by country: NL: 2026-04-29, BE: 2026-04-28, IT: 2026-04-29, FR: 2026-04-28

Condition(s): Sickle Cell Disease
Product: Anumigilimab, Saline 0.9%

Primary endpoint: Number and percentage of subjects with Treatment Emergent Adverse Events (TEAEs), overall and by severity, seriousness and relationship to Investigational Product (IP), Number and percentage of subjects with Adverse Events of Special Interest (AESIs), Clinically relevant changes from baseline in laboratory assessments and vital signs
Endpoint(s): From the first dose of anumigilimab through Week 65: • Serum anumigilimab, During the 52-week Maintenance Period: • Annualized rate of Vaso-occlusive crisis (VOC) (medical facility)

Source: https://euclinicaltrials.eu/ctis-public/view/2025-521154-42-00